EU clinical trial 2023-504417-67-00: An open-label, multi-center protocol for patients who have completed a previous Novartis sponsored Secukinumab study and are judged by the investigator to benefit from continued Secukinumab treatment
Protocol code: CAIN457A02001B
Sponsor: Novartis Pharma AG (Pharmaceutical company). Phase: Therapeutic use (Phase IV). Countries: Czechia (ongoing, recruiting), Spain (ongoing, recruiting), Poland (ongoing, recruiting), Bulgaria (ongoing, recruiting), Italy (ended), Portugal (ended), Belgium (authorised, recruitment pending), Germany (authorised, recruitment pending).
Therapeutic area(s): Diseases [C] - Immune System Diseases [C20]
Gender: Female, Male. Age: 0-17 years, 18-64 years, 65+ years. Enrolment: 328.
Start date (EU): 2020-12-22. Decision date: 2023-08-21. Results received: No. Last updated: 2026-08-06.
Decision dates by country: IT: 2024-07-09, PT: 2024-06-12, BG: 2023-09-20, CZ: 2023-08-21, PL: 2023-08-23, ES: 2023-08-22, DE: 2026-08-06, BE: 2025-11-19

Condition(s): Psoriatic Arthritis, Ankylosing Spondylitis, Non-radiographic Axial Spondyloarthritis, Severe Chronic Plaque Psoriasis, Moderate to severe Chronic Plaque Psoriasis, Juvenile idiopathic Arthritis
Product: SECUKINUMAB, SECUKINUMAB

Primary endpoint: Serious adverse events (SAEs), adverse events (AEs), and injection site reactions

Source: https://euclinicaltrials.eu/ctis-public/view/2023-504417-67-00